EU clinical trial 2024-510903-12-00: A stratification trial to determine key immunological factors predicting Tofacitinib efficacy in Psoriatic Arthritis (PsA); TOFA-PREDICT
Sponsor: Universitair Medisch Centrum Utrecht (Hospital/Clinic/Other health care facility). Phase: Therapeutic use (Phase IV). Countries: Netherlands (ended).
Therapeutic area(s): Diseases [C] - Immune System Diseases [C20]; Diseases [C] - Musculoskeletal Diseases [C05]
Gender: Female, Male. Age: 18-64 years, 65+ years. Enrolment: 160.
Status: Ended. End date (EU): 2025-12-08. Decision date: 2024-06-24. Results received: No. Last updated: 2024-09-06.

Condition(s): Psoriatic arthritis
Product: Foliumzuur Aurobindo 5 mg, tabletten, XELJANZ 5 mg film-coated tablets, METHOTREXAAT SANDOZ 2,5 MG, TABLETTEN, Methotrexaat Teva 20,0 mg, Oplossing voor injectie in een voorgevulde pen, Enbrel 50 mg solution for injection in pre-filled syringe, Methotrexaat Teva 25,0 mg, Oplossing voor injectie in een voorgevulde pen, Methotrexaat Teva 15 mg, Oplossing voor injectie in een voorgevulde pen

Primary endpoint: Minimal Disease Activity (MDA) at week 16, Baseline molecular network profile (based on the composite systems medicine analysis)
Endpoint(s): change (50%) in the molecular network before treatment as compared to after (week 4 and 16) treatment, change in composite clinical disease activity scores (MDA, ACR(20,50,70) response, DAS28) at week 16, change in individual clinical parameters that make up the composite scores (i.e. PASI score (reduction of 50%, 75%, 90%), joint count, CRP, ESR, QOL-measures) at week 16

Source: https://euclinicaltrials.eu/ctis-public/view/2024-510903-12-00